EU clinical trial 2025-521048-39-00: INITIATE-LECIG: Intestinal levodopa + entacapone therapy (Lecigon®) to counteract dopaminergic desensitization and neuropsychiatric complications in Parkinson’s disease
Protocol code: INITIATE-LECIG
Sponsor: Universitaetsklinikum Tuebingen AöR (Hospital/Clinic/Other health care facility). Phase: Therapeutic confirmatory (Phase III). Countries: Germany (ongoing, recruiting).
Therapeutic area(s): Diseases [C] - Nervous System Diseases [C10]
Gender: Female, Male. Age: 18-64 years, 65+ years. Enrolment: 150.
Status: Ongoing, recruiting. Start date (EU): 2025-10-28. Decision date: 2025-08-04. Results received: No. Last updated: 2026-08-06.

Condition(s): Parkinson Disease
Product: Lecigon 20 mg/ml + 5 mg/ml + 20 mg/ml Gel zur intestinalen Anwendung

Primary endpoint: To show superiority of LECIG therapy compared to best medicaltreatment on “hyperdopaminergic symptoms” corresponding toSection 1 (items 2 & 4), and section 4 (all items) of the “ArdouinBehavioural Scale” between pre-interventional baseline and 6-month follow-up

Source: https://euclinicaltrials.eu/ctis-public/view/2025-521048-39-00